EU clinical trial 2025-521856-47-00: Treatment of Bile Acid Diarrhoea with Atorvastatin (BASTA)
Protocol code: 2025-521856-47-00
Sponsor: Gentofte Hospital (Hospital/Clinic/Other health care facility). Phase: Phase III and phase IV (Integrated). Countries: Denmark (ongoing, recruiting).
Therapeutic area(s): Diseases [C] - Digestive System Diseases [C06]
Gender: Female, Male. Age: 18-64 years, 65+ years. Enrolment: 20.
Status: Ongoing, recruiting. Start date (EU): 2025-09-29. Decision date: 2025-06-04. Results received: No. Last updated: 2026-07-06.

Condition(s): Bile acid diarrhoea
Product: Atorvastatin Viatris 40 mg Filmtabletten, PLACEBO

Primary endpoint: Ratio of geometric mean concentration of 7alpha-Hydroxy-4-cholesten-3-on (C4) at the end of the 80 mg atorvastatin treatment period compared to the end of the placebo treatment period.
Endpoint(s): Difference in mean concentration of 7alpha-Hydroxy-4-cholesten-3-on (C4) in µg/L at the end of the 80 mg atorvastatin treatment period compared to the end of the placebo treatment period., Difference in mean daily stools during the last week of the 80 mg atorvastatin treatment period compared to the last week of the placebo treatment period as assessed by a 7-day stool diary., Difference in mean daily watery stools during the last week of the 80 mg atorvastatin treatment period compared to the last week of the placebo treatment period as assessed by the total watery (6 or 7 on the Bristol Stool Chart) stools in a 7-day stool diary, Difference in mean Irritable Bowel Syndrome Symptom Severity Score (IBS-SSS), Danish translation, questionnaire., Difference in proportion of patients with a reduction of C4 to below the threshold of 31 µg/L (%)., Difference in proportion of patients with a reduction of C4 to below the threshold of 46 µg/L (%)., Ratio of geometric mean of Fibroblast growth factor 19 (FGF-19) (pg/mL)., Ratio of geometric mean of blood levels of total bile acids (µmol/L)., Ratio of geometric mean of stool sample levels of total bile acids (µmol/g)., Mean difference of total cholesterol (mmol/L)., Mean difference of low-density lipoprotein (LDL) cholesterol (mmol/L).

Source: https://euclinicaltrials.eu/ctis-public/view/2025-521856-47-00